EU clinical trial 2025-524877-18-00: Pilot Study - Safety and Efficacy of Dalbavancin in Early Outpatient Treatment of Erysipelas and Limited Cellulitis
Protocol code: SIWIDA-FAT 001
Sponsor: Gemeinnutzige Salzburger Landes kliniken Betriebsgesellschaft mbH (Hospital/Clinic/Other health care facility). Phase: Therapeutic use (Phase IV). Countries: Austria (authorised, recruitment pending).
Therapeutic area(s): Diseases [C] - Skin and Connective Tissue Diseases [C17]; Diseases [C] - Bacterial Infections and Mycoses [C01]
Gender: Female, Male. Age: 18-64 years, 65+ years. Enrolment: 50.
Status: Authorised, recruitment pending. Decision date: 2026-04-07. Results received: No. Last updated: 2026-04-07.

Condition(s): Acute bacterial skin and skin structure infection (ABSSSI) Erysipelas
Product: Xydalba 500 mg powder for concentrate for solution for infusion

Primary endpoint: Percentage of patients who are dischargeable 48-72 hours after the Dalbavancin infusion due to sufficient infection control., Incidence of adverse events during therapy (up to day 28)., Incidence of Dalbavancin-associated adverse events.
Endpoint(s): Proportion of patients who do not require readmission between hospital discharge and follow-up evaluation associated with infection., Percentage of inpatient patients who can be discharged on day 8 due to sufficient infection control, Proportion of patients who require readmission on day 8 due to insufficient infection control., Duration of hospitalization., Infection-associated rehospitalization rate within 4 weeks after discharge., Percentage of patients without recurrent BHWI within 4 weeks after discharge., Proportion of patients without recurrent BHWI within a 4-6 week follow-up period., Percentage of patients requiring a change in antibiotic therapy (regimen change) within 14 days of starting treatment., Proportion of patients with adequate antibiotic coverage by Dalbavancin according to the antibiogram.

Source: https://euclinicaltrials.eu/ctis-public/view/2025-524877-18-00